EU clinical trial 2023-504139-42-00: A Phase I/II Open-label Dose Escalation and Dose Expansion Study to Evaluate the Safety, Pharmacokinetics, Pharmacodynamics, and Efficacy of AZD5863, a T cell-engaging Bispecific Antibody that Targets Claudin 18.2 (CLDN18.2) and CD3 in Adult Participants with Advanced or Metastatic Solid Tumors.
Protocol code: D9750C00001
Sponsor: AstraZeneca AB (Pharmaceutical company). Phase: Phase I and Phase II (Integrated)- First administration to humans. Countries: Netherlands (ongoing, recruiting), France (ongoing, recruiting).
Therapeutic area(s): Analytical,Diagnostic,Therapeutic Techniques and Equipment [E]-Surgical Procedures, Operative [E04]; Diseases [C] - Neoplasms [C04]
Gender: Female, Male. Age: 18-64 years, 65+ years. Enrolment: 48.
Status: Ongoing, recruiting. Start date (EU): 2024-09-06. Decision date: 2023-11-06. Results received: No. Last updated: 2025-11-13.
Decision dates by country: NL: 2023-11-06, FR: 2024-01-08

Condition(s): Advanced or metastatic solid tumors
Product: AZD5863, RoActemra 20 mg/mL concentrate for solution for infusion, RoActemra 20 mg/mL concentrate for solution for infusion, RoActemra 20 mg/mL concentrate for solution for infusion

Primary endpoint: Dose Escalation: Incidence of AEs, AESIs, DLTs and SAEs, Dose Escalation: AEs leading to discontinuation of AZD5863, Dose Escalation: Assess clinically significant alterations in vital signs and abnormal laboratory parameters, Dose Expansion: Incidence of AEs, AESIs and SAEs, Dose Expansion: AEs leading to discontinuation of AZD5863, Dose Expansion: Assess clinically significant alterations in vital signs and abnormal laboratory parameters, Dose Expansion: According to RECIST v1.1: ORR
Endpoint(s): Dose Escalation: According to RECIST v1.1: ORR, Dose Escalation and Dose Expansion: According to RECIST v1.1: DCR, DoR, PFS, Dose Escalation and Dose Expansion: Overall Survival, Dose Escalation and Dose Expansion: Serum concentrations of AZD5863, Dose Escalation and Dose Expansion: Serum PK parameters of AZD5863, including but not limited to Cmax, AUC, clearance and t1/2, as data allow, Dose Escalation and Dose Expansion: The number and percentage of participants who develop ADAs measured in serum, Dose Escalation and Dose Expansion: To investigate CLDN18.2 expression in tumour cells in relation to response to AZD5863

Source: https://euclinicaltrials.eu/ctis-public/view/2023-504139-42-00